EU clinical trial 2025-522551-25-00: A Double-blind, Placebo-controlled, Multiple-Dose, 2-Period Crossover Study to Evaluate the Effect of Steady-state AZD6793 on the Steady-state Pharmacokinetics/Pharmacodynamics of Metformin in Participants with Type 2 Diabetes Mellitus
Protocol code: D7860C00005
Sponsor: AstraZeneca AB (Pharmaceutical company). Phase: Human Pharmacology (Phase I)- Other. Countries: Germany (ongoing, recruiting).
Therapeutic area(s): Diseases [C] - Nutritional and Metabolic Diseases [C18]
Gender: Female, Male. Age: 18-64 years, 65+ years. Enrolment: 35.
Status: Ongoing, recruiting. Start date (EU): 2026-07-01. Decision date: 2025-11-27. Results received: No. Last updated: 2026-07-01.

Condition(s): Type 2 Diabetes Mellitus

Source: https://euclinicaltrials.eu/ctis-public/view/2025-522551-25-00